EU clinical trial 2023-504795-20-00: A Single Arm, Open-Label, Phase 1b Trial of Epcoritamab in Pediatric Patients with Relapsed/ Refractory Aggressive Mature B-cell Neoplasms
Protocol code: M20-429
Sponsor: AbbVie Deutschland GmbH & Co. KG (Pharmaceutical company). Phase: Human Pharmacology (Phase I)- Other. Countries: Italy (ended), Germany (ended), Czechia (ended), Spain (ended), France (ended), Belgium (ended).
Therapeutic area(s): Diseases [C] - Neoplasms [C04]
Gender: Female, Male. Age: 0-17 years. Enrolment: 6.
Status: Ended. Start date (EU): 2022-05-20. End date (EU): 2026-05-09. Decision date: 2023-11-14. Results received: No. Last updated: 2026-03-27.
Decision dates by country: FR: 2023-11-28, ES: 2023-11-14, DE: 2023-11-14, BE: 2023-12-04, CZ: 2023-11-15, IT: 2023-11-15

Condition(s): Relapsed/Refractory Aggressive Mature B-cell Neoplasms
Product: Epcoritamab (GEN3013), Epcoritamab (GEN3013)

Primary endpoint: The primary endpoints are safety and tolerability, including AESIs of Cytokine Release Syndrome (CRS), Immune Cell-Associated Neurotoxicity Syndrome (ICANS), and Clinical Tumor Lysis Syndrome (CTLS), and PK parameters of epcoritamab monotherapy.
Endpoint(s): CR per the International Pediatric Non-Hodgkin Lymphoma Response Criteria, Event-free survival (EFS), Overall survival (OS), Rate of initiation of stem cell transplantation or chimeric antigen receptor T-cell (CAR-T) therapy, Overall response (OR), Duration of response (DOR), Duration of CR (DOCR), Immunogenicity ([ADA] and neutralizing anti-drug antibodies (nAb))

Source: https://euclinicaltrials.eu/ctis-public/view/2023-504795-20-00